EU clinical trial 2025-522358-38-02: Post-operative analgesia and spinal block duration following total hip arthroplasties - comparison of single-shot intrathecal ropivacaine, and bupivacaine: a randomized, double blinded controlled study
Sponsor: Turku University Hospital (Hospital/Clinic/Other health care facility). Phase: Therapeutic use (Phase IV). Countries: Finland (authorised, recruitment pending).
Therapeutic area(s): Diseases [C] - Musculoskeletal Diseases [C05]
Gender: Female, Male. Age: 18-64 years, 65+ years. Enrolment: 162.
Status: Authorised, recruitment pending. Decision date: 2025-10-31. Results received: No. Last updated: 2026-04-30.

Condition(s): Hip osteoarthrosis and postoperative pain
Product: Bicain Spinal 5 mg/ml injektioneste, liuos, Ropivacain Fresenius Kabi 5 mg/ml injektioneste, liuos

Primary endpoint: Return of sensory and motor function
Endpoint(s): Post-operative pain evaluated using the Numeric Rating Scale (NRS), Urinary retention, Post-operative nausea and vomiting, Postoperative opioid consumption in morphine milligram equivalents (MME), Patient satisfaction will be evaluated using a 5-point Likert scale, Perioperative hemodynamics, Onset time of block, Adequacy of anesthesia, Same day discharge rate, Length of stay in the postoperative care unit and length of hospital stay

Source: https://euclinicaltrials.eu/ctis-public/view/2025-522358-38-02